EU clinical trial 2022-502814-99-00: A Phase 1, Open-label, Randomized, 2-Part, 2-Way Crossover Study in Healthy Adult Participants to Assess the Relative Bioavailability of Tablet Formulations of Lazertinib (JNJ-73841937)
Sponsor: Janssen - Cilag International (Pharmaceutical company). Phase: Human Pharmacology (Phase I)- Bioequivalence Study. Countries: Belgium (ended).
Therapeutic area(s): Diseases [C] - Respiratory Tract Diseases [C08]
Gender: Female, Male. Age: 18-64 years. Enrolment: 72.
Status: Ended. Start date (EU): 2023-05-30. End date (EU): 2023-09-01. Decision date: 2023-04-05. Results received: Yes. Last updated: 2023-10-03.

Condition(s): Non-small cell lung cancer (NSCLC)
Product: JNJ-73841937, JNJ-73841937

Primary endpoint: Pharmacokinetic parameters for the reference and test interventions: Cmax, AUC0-72h.

Source: https://euclinicaltrials.eu/ctis-public/view/2022-502814-99-00